EU clinical trial 2024-514230-20-00: Long-term iron chelation in the prevention of secondary remote degeneration after stroke
Protocol code: CHUBX 2019/49
Sponsor: Centre Hospitalier Universitaire De Bordeaux (Hospital/Clinic/Other health care facility). Phase: Therapeutic exploratory (Phase II). Countries: France (ended).
Therapeutic area(s): Diseases [C] - Nervous System Diseases [C10]
Gender: Female, Male. Age: 18-64 years, 65+ years. Enrolment: 100.
Status: Ended. Start date (EU): 2022-06-08. End date (EU): 2025-04-22. Decision date: 2024-08-20. Results received: No. Last updated: 2024-08-20.

Condition(s): Stroke
Product: Ferriprox 500 mg film-coated tablets

Primary endpoint: Variation of iron as measured by R2* (95th percentile) between the baseline MRI (performed before day 5) and the 6 month MRI, within the substantia nigra ipsilateral to stroke in the group of patients randomized to receive Deferiprone
Endpoint(s): The variation of iron as measured by R2* (95th percentile) between the baseline MRI (performed before day 5) and the 6 month MRI, within the thalamus ipsilateral to stroke (whole thalamus and median nucleus) in the group of patients randomized to receive Deferiprone, The variation of R2* and of values from quantitative susceptibility mapping (QSM) between the baseline MRI (performed before day 5) and the 6 month MRI with a voxel-by-voxel quantification in patients randomized to receive Deferiprone versus those who will not receive Deferiprone, The clinical scores at 3 months and 6 months in patients randomized to receive Deferiprone and in patients from the control group: functional outcome assessed by the upper limb Fugl-Meyer scale, the Box and Block test and the modified Rankin scale (mRS); cognitive outcome assessed by the Montreal cognitive assessment (MoCA), and mood disorders assessed by the center for epidemiologic studies depression scale (CESD) and the generalized anxiety disorder scale (GAD-7)

Source: https://euclinicaltrials.eu/ctis-public/view/2024-514230-20-00